EU clinical trial 2023-508029-28-00: eGPA and local inflammation within the ENT area; Impact of Mepolizumab treatment on the nasal microbiome and local and systemic immune response in eosinophilic granulomatosis with polyangitis (eGPA)
Protocol code: NL83176.042.23
Sponsor: Universitair Medisch Centrum Groningen (Hospital/Clinic/Other health care facility). Phase: Therapeutic use (Phase IV). Countries: Netherlands (ongoing, recruiting).
Therapeutic area(s): Diseases [C] - Immune System Diseases [C20]
Gender: Female, Male. Age: 18-64 years, 65+ years. Enrolment: 150.
Status: Ongoing, recruiting. Start date (EU): 2024-02-13. Decision date: 2024-02-02. Results received: No. Last updated: 2024-02-02.

Condition(s): Eosinophilic Granulomatosis with Polyangiitis (eGPA)
Product: MEPOLIZUMAB

Primary endpoint: The effect mepolizumab treatment has on the nasal microbiome profiles after three months of treatment

Source: https://euclinicaltrials.eu/ctis-public/view/2023-508029-28-00